EU clinical trial 2024-513984-22-00: LENVAGIST - A multicentre, comparative, placebo-controlled, double-blinded, phase II study of the efficacy of lenvatinib in patients with locally advanced or metastatic GIST after failure of imatinib and sunitinib
Sponsor: Centre Leon Berard (Hospital/Clinic/Other health care facility). Phase: Therapeutic exploratory (Phase II). Countries: France (ended).
Therapeutic area(s): Diseases [C] - Neoplasms [C04]
Gender: Female, Male. Age: 18-64 years, 65+ years. Enrolment: 74.
Status: Ended. Start date (EU): 2020-03-17. End date (EU): 2025-03-12. Decision date: 2024-08-22. Results received: Yes. Last updated: 2025-11-19.

Condition(s): Patients with metastatic GIST
Product: LENVIMA 10 mg hard capsules, This refers to placebo number: PL1 (LENVIMA) Pharmaceutical form: Capsule Route of administration: Oral use, LENVIMA 4 mg hard capsules

Primary endpoint: The primary endpoint will be the Progression-Free Survival (PFS)
Endpoint(s): Overall survival is defined as the time from the date of randomisation until the date of death due to any cause., Objective Response Rate (ORR) is the proportion of patients with a Complete Response or Partial Response as Best Overall Response., Best Overall Response (BOR) is described as the proportion of patients with a best overall response of Complete Response., The patient's Quality of Life will be assessed using the EORTC QLQ-C30., The tolerance profile will be described mainly on the frequency of adverse events coded using the common toxicity criteria (NCI-CTC v5.0) grade.

Source: https://euclinicaltrials.eu/ctis-public/view/2024-513984-22-00